EU clinical trial 2024-515487-31-00: Study on Pharmacokinetics of newly developed ANtiretroviral agents in HIV-infected pregNAnt women (PANNA)
Protocol code: 103900
Sponsor: Stichting Radboud universitair medisch centrum (Hospital/Clinic/Other health care facility). Phase: Therapeutic use (Phase IV). Countries: Spain (ended), Ireland (ended), Netherlands (ended), Belgium (ended), Germany (ended).
Therapeutic area(s): Diseases [C] - Virus Diseases [C02]
Gender: Female. Age: 18-64 years. Enrolment: 163.
Status: Ended. End date (EU): 2025-12-12. Decision date: 2024-10-16. Results received: No. Last updated: 2024-10-22.
Decision dates by country: BE: 2024-10-21, DE: 2024-10-21, IE: 2024-10-17, ES: 2024-10-22, NL: 2024-10-16

Condition(s): HIV-infected
Product: Ziagen 300 mg film-coated tablets, INTELENCE 200 mg tablets, Eviplera 200 mg/25 mg/245 mg film-coated tablets, EDURANT 25 mg film-coated tablets, Telzir 700 mg film-coated tablets, TRIZIVIR 300 mg/150 mg/300 mg film-coated tablets, Delstrigo 100 mg/300 mg/245 mg film-coated tablets, Norvir 100 mg film-coated tablets, Ritonavir Accord 100 mg filmomhulde tabletten, Descovy 200 mg/10 mg film-coated tablets, REYATAZ 300 mg hard capsules, REKAMBYS 600 mg prolonged-release suspension for injection, Tivicay 50 mg film-coated tablets, REKAMBYS 900 mg prolonged-release suspension for injection, Viread 245 mg film-coated tablets, Emtriva 200 mg hard capsules, Descovy 200 mg/25 mg film-coated tablets, CELSENTRI 300 mg film-coated tablets, Truvada 200 mg/245 mg film-coated tablets, Biktarvy 50 mg/200 mg/25 mg film-coated tablets, Odefsey 200 mg/25 mg/25 mg film-coated tablets, STOCRIN 600 mg film-coated tablets, Vocabria 400 mg prolonged-release suspension for injection, INTELENCE 100 mg tablets, Aptivus 250 mg soft capsules, Pifeltro 100 mg film-coated tablets, CELSENTRI 150 mg film-coated tablets, Kivexa 600 mg/300 mg film-coated tablets, ISENTRESS 400 mg film-coated tablets, Fuzeon 90 mg/ml powder and solvent for solution for injection, Vocabria 600 mg prolonged-release suspension for injection, ISENTRESS 600 mg film-coated tablets

Primary endpoint: AUC0-tau; Cmax; Ctrough, tmax, thalf for pregnant women. Comparison between these parameters during pregnancy and the parameters after pregnancy using mixed model analysis ., Ctrough in pregnancy should be above the minimal effective plasma concentration., Cord blood/maternal blood concentration ratio at delivery., Determination of half life in infants after in utero exposure if applicable (washout half life)., Breastmilk/maternal plasma ratio in case of breastfeeding and exposure in child if breastfeeding.
Endpoint(s): Description of maternal viral suppression during pregnancy and postpartum., Description of infection status of infants at birth., Description of SAEs and AEs reported during pregnancy and postpartum.

Source: https://euclinicaltrials.eu/ctis-public/view/2024-515487-31-00